EU clinical trial 2022-501453-36-00: EORTC 2129-BCG: Elacestrant for treating ER+/HER2- breast cancer patients with ctDNA relapse (TREAT ctDNA)
Protocol code: EORTC 2129-BCG
Sponsor: European Organisation For Research And Treatment Of Cancer (Patient organisation/association). Phase: Therapeutic confirmatory (Phase III). Countries: Belgium (ongoing, recruiting), France (ongoing, recruiting), Germany (ongoing, recruiting), Ireland (ongoing, recruiting), Italy (ongoing, recruiting), Greece (ongoing, recruiting), Portugal (ongoing, recruiting), Cyprus (ongoing, recruiting), Netherlands (ongoing, recruiting), Spain (ongoing, recruiting), Sweden (ongoing, recruiting).
Therapeutic area(s): Diseases [C] - Neoplasms [C04]
Gender: Female, Male. Age: 18-64 years, 65+ years. Enrolment: 215.
Status: Ongoing, recruiting. Start date (EU): 2024-02-23. Decision date: 2023-11-10. Results received: No. Last updated: 2026-08-03.
Decision dates by country: SE: 2024-05-14, NL: 2024-03-18, CY: 2024-04-04, ES: 2024-04-02, FR: 2023-11-15, DE: 2023-11-15, BE: 2023-11-10, GR: 2024-04-08, IE: 2023-11-15, IT: 2023-11-15, PT: 2024-03-14

Condition(s): Breast cancer
Product: LETROZOLE, ANASTROZOLE, ELACESTRANT, ELACESTRANT, TAMOXIFEN, LETROZOLE, TAMOXIFEN, TAMOXIFEN, TAMOXIFEN, EXEMESTANE

Primary endpoint: Distant metastasis free survival (DMFS) defined as the time from randomisation until first distant metastatic recurrence or death from any cause, whichever occurs first
Endpoint(s): Invasive disease-free survival (iDFS) rate according to the STEEP criteria including locoregional recurrence, distant metastasis, invasive contralateral breast cancer and invasive non-breast second cancers, deaths from any cause as events, Relapse-free survival (RFS) rate according to the STEEP criteria, including locoregional recurrence, distant metastasis, deaths from any cause as events, Overall survival rate, Safety including but not limited to all adverse events, serious adverse events, laboratory abnormalities graded according to CTCAE version 5.0, Patient reported outcomes: tolerability & benefit as measured by the QLQ-C30, QLQ-BR42 and EORTC IL46

Source: https://euclinicaltrials.eu/ctis-public/view/2022-501453-36-00